EU clinical trial 2023-504458-36-02: Evaluation of the expression of somatostatin receptors in DOTATOC-68Ga PET scans in patients followed for metastatic breast cancer
Protocol code: 38RC21.0432
Sponsor: Centre Hospitalier Universitaire Grenoble Alpes (Hospital/Clinic/Other health care facility). Phase: Therapeutic exploratory (Phase II). Countries: France (ongoing, recruiting).
Therapeutic area(s): Diseases [C] - Pathological Conditions, Signs and Symptoms [C23]
Gender: Female. Age: 18-64 years, 65+ years. Enrolment: 25.
Status: Ongoing, recruiting. Start date (EU): 2024-09-26. Decision date: 2024-07-04. Results received: No. Last updated: 2026-01-26.

Condition(s): Breast Cancer
Product: SomaKit TOC 40 micrograms kit for radiopharmaceutical preparation

Primary endpoint: Lésion métastatique présentant une surexpression des récepteurs SST2 par TEP au 68Ga-DOTATOC (score Krenning ≥2).
Endpoint(s): Analyse par lésion de l’intensité de la fixation des lésions en TEP au 68Ga-DOTATOC (score de Krenning et paramètres de quantification TEP)., Quantification du volume de la maladie par patiente présentant une surexpression des récepteurs SST2 en TEP au 68Ga-DOTATOC en comparaison au volume métabolique en TEP au 18F-FDG, Analyse par site métastatique de l’intensité de la fixation des lésions en TEP au 68Ga-DOTATOC (score de Krenning et paramètres de quantification TEP)., Comparer entre la TEP au 68Ga-DOTATOC et TEP au 18F-FDG (score de Krenning et paramètre de quantification TEP) par lésion et par patient., Recueil des données clinico-biologiques et d’imagerie précédent la TEP au 68Ga-DOTATOC par patiente, Recueil des données clinico-biologiques et d’imagerie précédent la TEP au 68Ga-DOTATOC par lésion

Source: https://euclinicaltrials.eu/ctis-public/view/2023-504458-36-02